EU clinical trial 2024-511043-25-00: A Phase 3 study of MK-4280A (coformulated favezelimab [MK-4280] plus pembrolizumab [MK-3475]) Versus Standard of Care in Previously Treated Metastatic PD-L1 positive Colorectal Cancer (KEYFORM-007)
Protocol code: MK-4280A-007
Sponsor: Merck Sharp & Dohme LLC (Pharmaceutical company). Phase: Therapeutic confirmatory (Phase III). Countries: Italy (ended), Norway (ended), France (ended), Spain (ended).
Therapeutic area(s): Diseases [C] - Neoplasms [C04]
Gender: Female, Male. Age: 18-64 years, 65+ years. Enrolment: 102.
Status: Ended. Start date (EU): 2021-11-30. End date (EU): 2025-02-21. End date: 2025-02-22. Decision date: 2024-05-21. Results received: Yes. Last updated: 2025-02-04.
Decision dates by country: IT: 2024-05-28, NO: 2024-05-21, FR: 2024-05-23, ES: 2024-05-21

Condition(s): Colorectal Cancer
Product: MK-4280A, TRIFLURIDINE, COMBINATIONS, REGORAFENIB

Primary endpoint: Overall Survival (OS)
Endpoint(s): Progression-Free Survival (PFS) according per Response Evaluation Criteria in Solid Tumors Version 1.1 (RECIST 1.1) as assessed by Blinded Independent Central Review (BICR), Objective Response Rate (ORR) per RECIST 1.1 as Assessed by BICR, Duration of Response (DOR) per RECIST 1.1 as Assessed by BICR, Number of Participants Who Experience at least One Adverse Event (AE), Number of Participants Who Discontinue Study Treatment Due to an AE, Change from Baseline in European Organisation for Research and Treatment of Cancer Quality of Life Questionnaire-Core 30 (EORTC QLQ-C30) Global Health Status (Item 29) and Quality of Life (Item 30) Combined Score, Change from Baseline in EORTC QLQ-C30 Physical Functioning (Items 1-5) Score, Change from Baseline in EORTC QLQ-C30 Appetite Loss (Item 13) Score, Change from Baseline in EORTC Quality of Life Questionnaire-Colorectal Cancer-Specific 29 Items (QLQ-CR29) Bloating (Item 37) Score, Time to Deterioration (TTD) in EORTC QLQ-C30 Global Health Status (Item 29) and Quality of Life (Item 30) Combined Score, TTD in EORTC QLQ-C30 Physical Functioning (Items 1-5) Combined Score, TTD in EORTC QLQ-C30 Appetite Loss (Item 13) Score, TTD in EORTC Quality of Life Questionnaire-Colorectal Cancer-Specific 29 Items (QLQ-CR29) Bloating (Item 37) Score

Source: https://euclinicaltrials.eu/ctis-public/view/2024-511043-25-00